EU clinical trial 2024-513375-40-00: Phase II, single arm, multicentre clinical trial to evaluate the activity of encorafenib plus binimetinib followed by Cemiplimab And Fianlimab in patients with BRAF mutated melanoma and symptomatic brain metastases.
Protocol code: GEM 2301
Sponsor: Grupo Espanol Multidisciplinar De Melanoma (Patient organisation/association). Phase: Therapeutic exploratory (Phase II). Countries: Spain (ongoing, recruiting).
Therapeutic area(s): Diseases [C] - Neoplasms [C04]
Gender: Female, Male. Age: 18-64 years, 65+ years. Enrolment: 33.
Status: Ongoing, recruiting. Start date (EU): 2025-05-16. Decision date: 2025-04-01. Results received: No. Last updated: 2025-11-25.

Condition(s): Melanoma
Product: Braftovi 75 mg hard capsules, LIBTAYO 350 mg concentrate for solution for infusion., Mektovi 15 mg film-coated tablets, Fianlimab, Braftovi 50 mg hard capsules

Primary endpoint: The primary endpoint for ENCEFALO is the 6 month intracranial progression-free survival (icPFS), defined as the proportion of patients alive and free of icPFS according to modified RECIST criteria (Section 10.3 and Appendix 3) at 6 month evaluation (week 24 +/- 3 weeks) after the start of study treatment. The icPFS will be assessed locally by investigators.
Endpoint(s): Efficacy Endpoints: 12-months icPFS: Percentage of patients free of icPFS according to modified RECIST criteria (Section 10.3 and Appendix 3) at 12 month evaluation (week 48 +/- 3 weeks)., Efficacy Endpoints: icPFS locally assessed according to modified RECIST criteria, median and global curve estimated by kaplan meier method, Efficacy Endpoints: ecPFS locally assessed according to modified RECIST criteria (Appendix 3), median and global curve estimated by kaplan meier method, Efficacy Endpoints: PFS locally assessed according to modified RECIST criteria (Appendix 3), median and global curve estimated by kaplan meier method, Efficacy Endpoints: OS locally assessed, median and global curve estimated by kaplan meier method, Efficacy Endpoints: Change in patient reported outcomes in Health-related quality of life (HRQoL), assessed through the European Organization for Research and Treatment of Cancer Quality of Life Questionnaire C30 (EORTC QLQ-C30) version 3 (Appendix 4)., Efficacy Endpoints:Changes in Barthel score from baseline (Appendix 5)., Efficacy Endpoints: Change in systemic steroids usage from baseline., Safety Endpoints: Type, incidence, frequency, severity and relation to the treatment of reported adverse events, physical examinations and laboratory tests: ○ Frequency and severity of adverse events assessed by NCI CTCAE v5.0 (Appendix 6). ○ Frequency of treatment-related adverse events (TRAEs) assessed by NCI CTCAE v5.0. ○ Frequency of AEs leading to treatment discontinuation.

Source: https://euclinicaltrials.eu/ctis-public/view/2024-513375-40-00